EU clinical trial 2025-522144-41-00: Randomized Phase II study of multi-peptide vaccination and bispecific PSMAxCD3 antibody treatment in patients with biochemical relapse of prostate cancer
Protocol code: ImmProCure
Sponsor: Universitaetsklinikum Tuebingen AöR (Hospital/Clinic/Other health care facility). Phase: Therapeutic exploratory (Phase II). Countries: Germany (authorised, recruitment pending).
Therapeutic area(s): Diseases [C] - Male Urogenital Diseases [C12]
Gender: Male. Age: 18-64 years, 65+ years. Enrolment: 84.
Status: Authorised, recruitment pending. Decision date: 2026-07-20. Results received: No. Last updated: 2026-08-07.
Decision dates by country: DE: 2026-08-07

Condition(s): biochemical relapse of prostate cancer

Source: https://euclinicaltrials.eu/ctis-public/view/2025-522144-41-00